EU clinical trial 2024-518365-10-00: A PHASE III, RANDOMIZED, OPEN-LABEL STUDY EVALUATING THE EFFICACY AND SAFETY OF DIVARASIB AND PEMBROLIZUMAB VERSUS PEMBROLIZUMAB AND PEMETREXED AND CARBOPLATIN OR CISPLATIN IN PATIENTS WITH PREVIOUSLY UNTREATED, KRAS G12C-MUTATED, ADVANCED OR METASTATIC NON-SQUAMOUS NON-SMALL CELL LUNG CANCER
Protocol code: CO45042
Sponsor: F. Hoffmann-La Roche AG (Pharmaceutical company). Phase: Therapeutic confirmatory (Phase III). Countries: Ireland (ongoing, recruiting), Greece (ongoing, recruiting), Hungary (ongoing, recruiting), Netherlands (ongoing, recruiting), France (ongoing, recruiting), Denmark (ongoing, recruiting), Germany (ongoing, recruiting), Poland (ongoing, recruiting), Italy (ongoing, recruiting), Portugal (ongoing, recruiting), Spain (ongoing, recruiting), Belgium (ongoing, recruiting).
Therapeutic area(s): Diseases [C] - Neoplasms [C04]
Gender: Female, Male. Age: 18-64 years, 65+ years. Enrolment: 282.
Status: Ongoing, recruiting. Start date (EU): 2025-10-28. Decision date: 2025-10-21. Results received: No. Last updated: 2026-08-04.
Decision dates by country: HU: 2025-10-27, NL: 2025-10-21, PL: 2025-10-29, PT: 2025-10-23, DE: 2025-10-22, BE: 2025-10-21, DK: 2025-10-21, IE: 2025-10-24, FR: 2025-10-21, IT: 2025-10-22, GR: 2025-10-21, ES: 2025-10-24

Condition(s): Previously Untreated Advanced or Metastatic Non-Squamous Non−Small Cell Lung Cancer
Product: RO7435846, Cisplatin NeoCorp 1 mg/ml - Konzentrat zur Herstellung einer Infusionslösung, CARBO-cell® 10 mg/ml Infusionslösung, Konzentrat zur Herstellung einer Infusionslösung, Pemetrexed Fresenius Kabi 25 mg/ml concentrate for solution for infusion, KEYTRUDA 25 mg/mL concentrate for solution for infusion, Carboplatin Bendalis 10mg/ml, Konzentrat zur Herstellung einer Infusionslösung, Carboplatin Kabi 10 mg/ml Konzentrat zur Herstellung einer Infusionslösung, Cisplatin Teva® 1 mg/ml Konzentrat zur Herstellung einer Infusionslösung, RO 743-5846/F04, CARBOPLATINE ACCORD 10 mg/ml, solution pour perfusion, RO 743-5846/F07, CISPLATINE ACCORD 1 mg/ml, solution à diluer pour perfusion, RO7435846, Pemetrexed Accord 25 mg/ml concentrate for solution for infusion, Budenofalk 3mg magensaftresistente Hartkapseln, Pemetrexed Fresenius Kabi 500 mg powder for concentrate for solution for infusion, KEYTRUDA 25 mg/mL concentrate for solution for infusion, PEMETREXED, CISPLATINE ACCORD 1 mg/ml, solution à diluer pour perfusion, CISPLATIN-EBEWE, 1 MG/ML, KONCENTRAT DO SPORZĄDZANIA ROZTWORU DO INFUZJI

Primary endpoint: PFS, defined as the time from randomization to disease progression, as determined by BICR according to RECIST v1.1, or death from any cause (whichever occurs first), OS, defined as time from randomization to death from any cause
Endpoint(s): Confirmed objective response, defined as CR or PR on two consecutive occasions ≥ 4 weeks apart, as determined by BICR according to RECIST v1.1, Change from baseline to Cycle 5 Day 1 on the European Organisation for Research and Treatment of Cancer (EORTC) QLQ-LC13 cough item (item 31), the QLQ-C30 dyspnea item (item 8), and the QLQ-C30 Physical Functioning scale (items 1−5), DOR, defined as the time from the first occurrence of a documented objective response to disease progression, as determined by BICR according to RECIST v1.1, or death from any cause, whichever occurs first, Incidence and severity of adverse events, with severity determined according to the National Cancer Institute Common Terminology Criteria for Adverse Events (NCI CTCAE) v5.0 grading scale, Change from baseline in selected vital signs and ECG parameters, Change from baseline in selected clinical laboratory test results, Presence, frequency of occurrence, severity, and/or degree of interference with daily function of selected symptomatic treatment toxicities as assessed by the NCI PRO-CTCAE, Worst post-baseline scores in the severity of selected symptomatic treatment toxicities as assessed by the NCI PRO-CTCAE, Frequency of participant’s response of the degree they are troubled with treatment symptoms, as assessed by the single-item European Organisation for Research and Treatment of Cancer (EORTC) Item List 46 (IL46), Change from baseline on the EORTC QLQ-C30 and QLQ-LC13 functional and global health status (GHS)/quality of life (QoL) scales, and symptoms to Cycle 5 Day 1 and throughout the trial

Source: https://euclinicaltrials.eu/ctis-public/view/2024-518365-10-00